EU clinical trial 2024-515914-41-00: A Phase 2b, Multicenter, Randomized, Open-label, Two-Arm Study to Evaluate the Clinical Efficacy and Safety of OHB-607 Compared to Standard Neonatal Care for the Prevention of Bronchopulmonary Dysplasia, the Most Common Cause of Chronic Lung Disease of Prematurity
Protocol code: OHB-607-202
Sponsor: Ohb Neonatology Limited (Pharmaceutical company). Phase: Therapeutic exploratory (Phase II). Countries: Spain (ongoing, recruitment ended), Italy (ongoing, recruitment ended), Portugal (ongoing, recruitment ended), Netherlands (ongoing, recruitment ended), Germany (ongoing, recruitment ended), Ireland (authorised, recruiting), Finland (ongoing, recruitment ended).
Therapeutic area(s): Diseases [C] - Respiratory Tract Diseases [C08]
Gender: Female, Male. Age: 0-17 years. Enrolment: 96.
Start date (EU): 2024-07-05. Decision date: 2024-10-11. Results received: No. Last updated: 2026-01-13.
Decision dates by country: IT: 2024-11-27, ES: 2024-10-24, FI: 2024-10-16, PT: 2024-10-15, NL: 2024-10-14, IE: 2024-10-11, DE: 2024-10-15

Condition(s): Chronic Lung Disease
Product: Mecasermin rinfabate

Primary endpoint: Incidence of severe BPD (as defined by the modified NICHD severity grading) or death for all subjects at or before 36 weeks (±3 days) PMA., • No BPD: oxygen for <28 days or none • Mild BPD: need for oxygen for ≥28 days but on room air at 36 weeks PMA • Moderate BPD: oxygen for ≥28 days plus treatment with <30% oxygen at 36 weeks PMA • Severe BPD: oxygen for ≥28 days plus oxygen ≥30% and/or any positive pressure ventilation (CPAP, IMV, NNIMV, or high flow nasal cannula ≥2 L/min) at 36 weeks PMA
Endpoint(s): Time to final weaning off of RTS from Day 1 of randomization through 12 months CA. The final weaning off of RTS is defined as the 7th consecutive day that the subject is off RTS., Incidence of Grade 2 and Grade 3 (severe) BPD (as per modified Jensen severity grading) or death at 36 weeks PMA. Definitions for BPD are based on Jensen et al., 2019: • No BPD: no support. • Grade 1: nasal cannula ≤2 L/min. • Grade 2: nasal cannula >2 L/min or noninvasive positive airway pressure (CPAP/NIPPV). • Grade 3: invasive mechanical ventilation (IMV)., • No BPD: no support • Grade 1: supplemental oxygen <2 L/min without positive pressure (including nasal cannula) • Grade 2: positive pressure support (including CPAP, nasal cannula oxygen ≥2 L/min, NIPPV) • Grade 3: positive pressure ventilation (high-frequency oscillation ventilation and technologies with positive pressure tidal volume breaths, such as IMV, Incidence of severe (Grade 3 and 4) IVH before 40 weeks PMA (or NICU discharge/transfer, whichever comes first) as assessed by central blinded reviewers and classified per Volpe criteria (Inder et al., 2018): • Grade 1: blood in germinal matrix with/without IVH <10% of ventricular space. • Grade 2: IVH occupying 10-50% of ventricular space on parasagittal view. • Grade 3: IVH >50% of ventricle or distends ventricle. • Grade 4: periventricular hemorrhagic infarction., Incidence of severe ROP (Stage 3 and above) up to 40 weeks PMA according to International Classification (International Committee for the Classification of Retinopathy of Prematurity, 2021) by local blinded reviewer., Respiratory severity scoring will be determined from information captured during follow-up telephone calls and clinical site visits at intervals specified until 12 months CA using CLDPSS (O’Brodovich et al., 2021)., Neurodevelopmental impairment as determined by the separate BSID III scales at 24 months CA. • Motor composite score • Cognitive composite score • Language composite score, To be collected through 24 months CA: • Total number of days on RTS in hospital and out of hospital • Number and duration in days of rehospitalizations due to respiratory diagnoses • Number of emergency room visits associated with a respiratory diagnosis • Number of days of respiratory medication use • Respiratory Risk Factors Assessment including breast feeding, vaccines and respiratory syncytial virus prophylaxis, exposure to tobacco, pets, and young children., Incidence of severity of all grades of BPD according to the modified NICHD guidelines for preterm infants born at <32 weeks GA, analyzed separately: none, mild, moderate, and severe BPD., Incidence of all severity grades of BPD as assessed by Jensen et al., 2019: • No BPD: no support • Grade 1: supplemental oxygen <2 L/min without positive pressure (including nasal cannula) • Grade 2: positive pressure support (including CPAP, nasal cannula oxygen ≥2 L/min, NIPPV) • Grade 3: positive pressure ventilation (highfrequency oscillation ventilation and technologies with positive pressure tidal volume breaths, such as IMV), Incidence of all grades of IVH as assessed by centrally read CUS and classified according to the Volpe criteria (Inder et al., 2018)., Physical and cognitive development as measured by ASQ-3 administered at 12 and 24 months CA., Incidence and severity of all stages of ROP through 40 weeks PMA according to International Classification (International Committee for the Classification of Retinopathy of Prematurity, 2021) by local blinded reviewer., Mortality rates from randomization to initial hospital discharge and from initial discharge through 24 months CA., Relationships between IGF-1 exposure and respiratory, neurologic, BPD, IVH, NEC, and ROP endpoints., • Incidence, severity & causality of AEs & SAEs • Fatal AEs • Changes from baseline in clinical safety lab parameters (primarily blood glucose), physical examination, and vital signs • IV access status • Central line use • Vision and hearing, • Vision and hearing • Concomitant medications or relevant procedures • Development of anti-IGF-1/IGFBP-3 antibodies (IgG and IgM) • Organ hypertrophy (heart, liver, spleen tonsillar, other organ growth) • Incidence of hemangiomas noted during routine clinical assessments

Source: https://euclinicaltrials.eu/ctis-public/view/2024-515914-41-00